EU clinical trial 2026-525568-17-00: Whole body HER2 quantification with 89Zr-Trastuzumab PET/CT to asses Zr-trastuzumab accumulation in HER2-mutated and HER2-overexpressing metastatic non-small cell lung cancer
Sponsor: Het Nederlands Kanker Instituut-Antoni van Leeuwenhoek Ziekenhuis Stichting (Hospital/Clinic/Other health care facility). Phase: Human Pharmacology (Phase I)- Other. Countries: Netherlands (authorised, recruitment pending).
Therapeutic area(s): Diseases [C] - Pathological Conditions, Signs and Symptoms [C23]; Diseases [C] - Respiratory Tract Diseases [C08]
Gender: Female, Male. Age: 18-64 years, 65+ years. Enrolment: 20.
Status: Authorised, recruitment pending. Decision date: 2026-07-30. Results received: No. Last updated: 2026-07-30.

Condition(s): HER2 mutation positive NSCLC

Source: https://euclinicaltrials.eu/ctis-public/view/2026-525568-17-00